EU clinical trial 2025-523978-16-00: A research study investigating the effect of NNC0497-0040 in healthy participants, participants with overweight or obesity, and participants with type 1 diabetes with overweight or obesity.
Protocol code: NN6497-8309
Sponsor: Novo Nordisk A/S (Pharmaceutical company). Phase: Human Pharmacology (Phase I)- First administration to humans. Countries: Germany (ongoing, recruiting).
Therapeutic area(s): Diseases [C] - Nutritional and Metabolic Diseases [C18]
Gender: Female, Male. Age: 18-64 years. Enrolment: 146.
Status: Ongoing, recruiting. Start date (EU): 2026-05-04. Decision date: 2026-04-23. Results received: No. Last updated: 2026-04-23.

Condition(s): Type I diabetes

Source: https://euclinicaltrials.eu/ctis-public/view/2025-523978-16-00